EU clinical trial 2023-505829-14-00: A randomized, open-label, multicentric, two-arm pivotal trial of SonoCloud-9 combined with carboplatin (CBDCA) vs standard of care lomustine (CCNU) or temozolomide (TMZ) in patients undergoing planned resection for first recurrence glioblastoma
Protocol code: SC9-GBM-03
Sponsor: Carthera (Pharmaceutical company). Phase: Therapeutic confirmatory (Phase III). Countries: Spain (ongoing, recruitment ended), Belgium (ongoing, recruiting), Italy (ongoing, recruitment ended), Austria (ongoing, recruiting), France (ongoing, recruiting), Germany (ongoing, recruitment ended), Netherlands (ongoing, recruiting), Denmark (ongoing, recruitment ended), Sweden (authorised, recruiting).
Therapeutic area(s): Diseases [C] - Neoplasms [C04]
Gender: Female, Male. Age: 18-64 years, 65+ years. Enrolment: 301.
Start date (EU): 2026-06-02. Decision date: 2023-11-07. Results received: No. Last updated: 2026-07-31.
Decision dates by country: SE: 2025-04-16, DK: 2025-03-31, FR: 2023-11-10, IT: 2023-11-07, DE: 2023-11-09, NL: 2023-11-13, AT: 2023-11-13, BE: 2023-11-07, ES: 2023-11-08

Condition(s): First recurrence glioblastoma
Product: Luminity 150 microlitres/ml gas and solvent for dispersion for injection/infusion, TEMOZOLOMIDE, Carboplatin 10 mg/ml Concentrate for Solution for Infusion, LOMUSTINE

Primary endpoint: Overall survival (OS), defined as the time from the date of randomization to the date of death due to any cause or censored at the time of last follow-up, calculated according to the Kaplan Meier method.
Endpoint(s): Progression Free Survival (PFS) Progression-free survival is defined as the time from randomization date to the earlier of the following events: unequivocal tumor progression as determined per RANO criteria or death due to any cause, Tumor Growth Rate Tumor Growth Rate will be determined by measuring hyperintense tumor volume using T1w contrast-enhancing tumor-related region from post-surgery MRI baseline to unequivocal progression MRI (i.e., suspected radiologic progression confirmed by repeat scan) or W20-22 MRI, whichever comes first, Overall survival at 9, 12, 18 and 24 months defined as rate of patients alive at 9, 12, 18 and 24 months (OS9, OS12, OS18, OS24), Response rate (in patients with evaluable disease, per RANO criteria), Rate of patients who are progression-free at 3,6 and 9 months (PFS3, PFS6, PFS9), Patient Reported Outcome will be assessed using the EQ-5D-5L, the EORTC QLQ-C30, and the EORTC QLQ-BN20 quality of life questionnaires at inclusion (baseline), 6 and 12 weeks after start of treatment as well as End-of-Trial Intervention visit. Patient Reported Outcome will be collected in all patients, irrespective of treatment arm and irrespective of subsequent line therapy initiated in the meantime

Source: https://euclinicaltrials.eu/ctis-public/view/2023-505829-14-00